EU clinical trial 2024-518447-38-00: Prospective, open-label, non-randomized, single-arm, dose titration study to investigate the efficacy and safety of IncobotulinumtoxinA in children deemed to require a total body dose up to 22U/kg (maximum dose 550U) during the study period for the treatment of upper and lower limb spasticity due to cerebral palsy. PROTOCOL CODE: INCIPIT
Protocol code: INCIPIT
Sponsor: Azienda Ospedaliera Universitaria Integrata Verona (Hospital/Clinic/Other health care facility). Phase: Therapeutic exploratory (Phase II). Countries: Italy (ongoing, recruiting).
Therapeutic area(s): Diseases [C] - Nervous System Diseases [C10]
Gender: Female, Male. Age: 0-17 years. Enrolment: 30.
Status: Ongoing, recruiting. Start date (EU): 2023-02-10. Decision date: 2024-10-29. Results received: No. Last updated: 2024-10-29.

Condition(s): multifocal spasticity of the upper and lower limb due to cerebral palsy
Product: XEOMIN, 100 unità, polvere per soluzione iniettabile

Primary endpoint: Changes in Ashworth scale values between the injection cycle baseline visits and the control ones of respective injection cycle (single interventional effect)
Endpoint(s): Efficacy endpoint: Scala di Ashworth, REsistance to PAssive movement Scale (REPAS), The GMFCS, The visual analog scale (VAS), The Goal Attainment scale (GAS), The Global Assessment of Efficacy, Safety endpoints: Values of blood pressure, heart rate, and respiratory rate, Values of Body Weight, adverse events, The Global Assessment of Tolerability

Source: https://euclinicaltrials.eu/ctis-public/view/2024-518447-38-00